EU clinical trial 2024-513442-10-00: EORTC 2237-BCG-QLG: Improvement of Quality of Life through supportive treatments for Endocrine Therapy – related symptoms in patients with early Breast cancer; A pragmatic randomized Controlled Trial (QOL-ET-BC)
Protocol code: EORTC 2237-BCG-QLG
Sponsor: Europese Organisatie Voor Onderzoek En Behandeling Van Kanker Organisation Europeenne Pour La Recherche Et Le Traitement Du Cancer European Organi (Patient organisation/association). Phase: Therapeutic confirmatory (Phase III). Countries: Spain (not authorised), Slovenia (not authorised), Poland (not authorised), France (not authorised), Cyprus (not authorised).
Therapeutic area(s): Diseases [C] - Neoplasms [C04]
Gender: Female, Male. Age: 18-64 years, 65+ years. Enrolment: 252.
Status: Not authorised. Decision date: 2025-02-11. Results received: No. Last updated: 2025-02-17.
Decision dates by country: CY: 2025-02-17, FR: 2025-02-17, SI: 2025-02-17, ES: 2025-02-11, PL: 2025-02-17

Condition(s): ER positive HER2 negative breast cancer stages I-II
Product: FUROSEMIDE, DULOXETINE

Primary endpoint: Change from baseline in the skeletal scale as assessed by the EORTC QLQ-BR42 at month 3. • The skeletal scale score is computed based on the following four individual items from the EORTC QLQ-BR42 questionnaire Have you had problems with your joints? • Have you had stiffness in your joints? • Have you had pain in your joints? • Have you had aches or pains in your bones?
Endpoint(s): Discontinuation of endocrine therapy, Change from baseline in the skeletal scale as assessed by the EORTC QLQ-BR42 questionnaire at month 6, Change from baseline in Global health status/QoL scale according to EORTC-QLQ-C30 questionnaire at 3 and 6 months, Change from baseline in Emotional functioning scale according to EORTC-QLQ-C30 questionnaire at 3 and 6 months, Change from baseline Endocrine therapy symptoms scale according to EORTC-BR42 questionnaire at 3 and 6 months, Safety according to the CTCAE (NCI Common Terminology Criteria for Adverse Events) Version 5.0 for toxicity and Serious Adverse Event reporting

Source: https://euclinicaltrials.eu/ctis-public/view/2024-513442-10-00